EU clinical trial 2022-501306-35-00: Pembro-CORE pilot - Phase II trial of Pembrolizumab in COmbination with salvage chemotherapy for first-RElapsed or refractory classical Hodgkin lymphoma
Protocol code: Uni-Koeln-3942
Sponsor: University Of Cologne (Educational Institution). Phase: Therapeutic exploratory (Phase II). Countries: Germany (ongoing, recruitment ended).
Therapeutic area(s): Diseases [C] - Neoplasms [C04]
Gender: Female, Male. Age: 18-64 years. Enrolment: 29.
Status: Ongoing, recruitment ended. Start date (EU): 2024-01-26. Decision date: 2023-06-05. Results received: No. Last updated: 2025-12-10.

Condition(s): First relapse or primary refractory of classical Hodgkin lymphoma
Product: ETOPOSIDE PHOSPHATE, CYTARABINE, KEYTRUDA 25 mg/mL concentrate for solution for infusion, IFOSFAMIDE, DEXAMETHASONE, CARBOPLATIN, CISPLATIN

Primary endpoint: Complete metabolic response (CMR) rate, defined as the proportion of patients with a Deauville score of 1-3 in the centrally reviewed restaging after treatment with 1 x pembrolizumab + 4 cycles of pembrolizumab and chemotherapy combined (4x P-ICE or 2x P-ICE + 2x P-DHAP).
Endpoint(s): Complete metabolic response rate after 2 cycles of combination therapy, Remission status after end of treatment including pembrolizumab consolidation, Proportion of patients receiving HDCT and autologous stem-cell transplantation (ASCT), Progression-free and overall survival after 1 and 2 years, Event-free survival after 1 and 2 years, defined as progression-free survival with the application of HDCT and ASCT counting as additional failure events, Adverse events, Patient-reported outcome (PRO-CTCAE, fatigue and quality of life)

Source: https://euclinicaltrials.eu/ctis-public/view/2022-501306-35-00